EU clinical trial 2024-518440-20-00: A Phase 1 Study to Evaluate the Safety, Tolerability, and Pharmacokinetics of T7-010 in Healthy Participants.
Protocol code: T7-010-01
Sponsor: T7 Therapeutics Inc. (Pharmaceutical company). Phase: Human Pharmacology (Phase I)- First administration to humans. Countries: Hungary (ended).
Therapeutic area(s): Diseases [C] - Immune System Diseases [C20]
Gender: Female, Male. Age: 18-64 years, 65+ years. Enrolment: 32.
Status: Ended. Start date (EU): 2025-09-16. End date (EU): 2026-06-30. Decision date: 2025-05-27. Results received: No. Last updated: 2026-04-29.

Condition(s): Autoimmune Diseases (Healthy Volunteers)

Source: https://euclinicaltrials.eu/ctis-public/view/2024-518440-20-00